EU clinical trial 2022-501570-18-00: Phase I study of AZD9592 in solid tumors
Protocol code: D9350C00001
Sponsor: Astrazeneca AB (Pharmaceutical company). Phase: Human Pharmacology (Phase I)- First administration to humans. Countries: Spain (ongoing, recruitment ended), France (ongoing, recruitment ended), Italy (ongoing, recruitment ended).
Therapeutic area(s): Diseases [C] - Neoplasms [C04]
Gender: Female, Male. Age: 18-64 years, 65+ years. Enrolment: 71.
Status: Ongoing, recruitment ended. Start date (EU): 2023-07-18. Decision date: 2023-05-17. Results received: No. Last updated: 2026-08-07.
Decision dates by country: IT: 2023-07-17, FR: 2023-09-08, ES: 2023-05-17

Condition(s): Locally Advanced or Metastatic Non-Small Cell Lung Cancer, Metastatic Colorectal Cancer, Recurrent or metastatic Head and NeckSquamous Cell Carcinoma of the oral cavity,oropharynx, hypopharynx or larynx

Source: https://euclinicaltrials.eu/ctis-public/view/2022-501570-18-00